EU clinical trial 2025-523635-19-00: Open-label proof-of-concept trial of topical delgocitinib in patients with facial vitiligo
Protocol code: DelVito
Sponsor: Gentofte Hospital (Hospital/Clinic/Other health care facility). Phase: Therapeutic exploratory (Phase II). Countries: Denmark (ongoing, recruitment ended).
Therapeutic area(s): Diseases [C] - Skin and Connective Tissue Diseases [C17]
Gender: Female, Male. Age: 18-64 years, 65+ years. Enrolment: 12.
Status: Ongoing, recruitment ended. Start date (EU): 2026-03-25. Decision date: 2026-01-12. Results received: No. Last updated: 2026-01-12.

Condition(s): Vitiligo
Product: Anzupgo 20 mg/g cream

Primary endpoint: Change in F-VASI from baseline to Week 24
Endpoint(s): Change in T-VASI from baseline to Week 24, Change in VESplus from baseline to Week 24, Change in VETF score from baseline to Week 24, Change in facial BSA from baseline to Week 24, Change in total BSA from baseline to Week 24, F-VASI50 at Week 24, F-VASI75 at Week 24, F-VASI90 at Week 24, Change in T-VASI at Weeks 4 and 12, Change in VESplus at Weeks 4 and 12, Change in VETF score at Weeks 4 and 12, F-VASI50 at Weeks 4 and 12, F-VASI75 at Weeks 4 and 12, F-VASI90 at Weeks 4 and 12, Change in DQOL from baseline to Week 24, Change in VitiQoL from baseline to Week 24, Change in WHO-5 from baseline to Week 24, Change in DQOL at Weeks 4 and 12, Change in VitiQoL at Weeks 4 and 12, Change in WHO-5 at Weeks 4 and 12, Frequency, duration, and severity of AEs, Changes in skin proteome and transcriptome from baseline to Weeks 4 and 24 (analyses will be performed if a change in F-VASI is shown)

Source: https://euclinicaltrials.eu/ctis-public/view/2025-523635-19-00